EU clinical trial 2022-502370-17-00: A randomized, double-blind, placebo-controlled, proof of concept study assessing the efficacy and safety of an anti-TNF-OX40L NANOBODY® molecule, SAR442970, in participants with moderate to severe hidradenitis suppurativa
Protocol code: ACT16852
Sponsor: Sanofi-Aventis Recherche & Developpement (Pharmaceutical company). Phase: Therapeutic exploratory (Phase II). Countries: Belgium (ended), Netherlands (ended), Sweden (ended), Denmark (ended), Czechia (ended), France (ended), Spain (ended), Greece (ended), Italy (ended), Germany (ended), Poland (ended).
Therapeutic area(s): Diseases [C] - Immune System Diseases [C20]
Gender: Female, Male. Age: 18-64 years, 65+ years. Enrolment: 51.
Status: Ended. Start date (EU): 2023-11-14. End date (EU): 2025-01-09. End date: 2025-01-10. Decision date: 2023-08-17. Results received: Yes. Last updated: 2024-10-17.
Decision dates by country: ES: 2023-08-21, BE: 2023-08-17, NL: 2023-08-21, SE: 2023-08-21, GR: 2023-08-17, DE: 2023-08-21, IT: 2023-08-18, DK: 2023-08-17, CZ: 2023-08-18, PL: 2023-08-21, FR: 2023-08-21

Condition(s): Hidradenitis suppurativa
Product: Matched Placebo for Test

Primary endpoint: Percentage of biologic and small molecule immunosuppressive naïve participants achieving Hidradenitis Suppurativa Clinical Response (HiSCR50)
Endpoint(s): Time to onset of achieving HiSCR50, Percentage of participants achieving HiSCR75 at Week 16, Percentage of participants achieving HiSCR90 at week 16, Percentage of participants who experience improvement by at least one International Hidradenitis Suppurativa Severity Score System (IHS4) stage at week 16, Change in absolute score from baseline in IHS4 at week 16, Percentage of participants who experience a flare, Percentage of participants achieving IHS4-55, Number of participants with treatment-emergent adverse events (TEAE), adverse events of special interest (AESI) and serious adverse events (SAE) including local reactions, Percentage of participants achieving at least 30% reduction and at least 1 unit reduction from baseline in weekly average of daily Hidradenitis Suppurativa Skin Pain Numeric Rating Scale (HS-Skin Pain NRS) at Week 16 among participants with baseline NRS ≥3, Serum SAR442970 concentrations throughout the study, Incidence of anti-SAR442970 antibody positive response throughout the study

Source: https://euclinicaltrials.eu/ctis-public/view/2022-502370-17-00